EU clinical trial 2024-511747-25-00: AN OPEN-LABEL STUDY TO ASSESS THE ANTI-TUMOR ACTIVITY AND SAFETY OF REGN1979, AN ANTI CD20 X ANTI-CD3 BISPECIFIC ANTIBODY, IN PATIENTS WITH RELAPSED OR REFRACTORY B CELL NON-HODGKIN LYMPHOMA
Protocol code: R1979-ONC-1625
Sponsor: Regeneron Pharmaceuticals Inc. (Pharmaceutical company). Phase: Therapeutic exploratory (Phase II). Countries: Spain (ongoing, recruitment ended), Germany (ongoing, recruitment ended), Italy (ongoing, recruitment ended), France (ongoing, recruitment ended), Poland (ongoing, recruitment ended).
Therapeutic area(s): Diseases [C] - Hemic and Lymphatic Diseases [C15]
Gender: Female, Male. Age: 18-64 years, 65+ years. Enrolment: 200.
Status: Ongoing, recruitment ended. Start date (EU): 2019-12-23. Decision date: 2024-05-28. Results received: No. Last updated: 2026-08-03.
Decision dates by country: ES: 2024-05-28, FR: 2024-05-28, IT: 2024-05-29, DE: 2024-05-30, PL: 2024-06-03

Condition(s): B-cell non-Hodgkin lymphoma (NHL)
Product: Odronextamab, Odronextamab, Odronextamab

Primary endpoint: The primary endpoint of the study for each of the 5 disease-specific cohorts is as follows: ORR according to the Lugano Classification of response in malignant lymphoma (Cheson, 2014) and as assessed by independent central review.
Endpoint(s): ORR according to the Lugano Classification and as assessed by local investigator evaluation, Complete response (CR) rate according to the Lugano Classification and as assessed by local investigator evaluation and independent central review., Progression free survival (PFS) according to the Lugano Classification and as assessed by independent central review and local investigator evaluation, Overall survival (OS), Duration of response (DOR) according to the Lugano Classification and as assessed by independent central review and local investigator evaluation, Disease control rate (DCR) according to the Lugano Classification and as assessed by independent central review and local investigator evaluation by independent central review and local investigator evaluation, Incidence and severity of treatment emergent adverse events (TEAEs), Pharmacokinetics: concentration of odronextamab, incidence of anti-drug antibodies (ADA) to odronextamab over time, incidence of neutralizing antibodies (Nab) to odronextamab over time, Changes in scores of patient-reported outcomes as measured by EORTC QLQ-C30, Changes in scores of patient-reported outcomes as measured by FACT-Lym, Changes in scores of patient-reported outcomes as measured by EQ-5D-3L

Source: https://euclinicaltrials.eu/ctis-public/view/2024-511747-25-00